EU clinical trial 2024-514404-13-00: A Prospective, Multicenter, Long-Term Study to Assess the Safety and Efficacy of Nemolizumab (CD14152) in Subjects with Moderate-to-Severe Atopic Dermatitis
Protocol code: RD.06.SPR.118163
Sponsor: Galderma S.A. (Pharmaceutical company). Phase: Therapeutic confirmatory (Phase III). Countries: Netherlands (ongoing, recruitment ended), Spain (ongoing, recruitment ended), France (ongoing, recruitment ended), Italy (ongoing, recruitment ended), Germany (ongoing, recruitment ended), Bulgaria (ongoing, recruitment ended), Latvia (ongoing, recruitment ended), Czechia (ongoing, recruitment ended), Estonia (ongoing, recruitment ended), Lithuania (ongoing, recruitment ended), Hungary (ongoing, recruitment ended), Belgium (ongoing, recruitment ended), Austria (ongoing, recruitment ended), Poland (ongoing, recruitment ended).
Therapeutic area(s): Diseases [C] - Skin and Connective Tissue Diseases [C17]
Gender: Female, Male. Age: 0-17 years, 18-64 years, 65+ years. Enrolment: 1164.
Status: Ongoing, recruitment ended. Start date (EU): 2020-10-01. Decision date: 2024-08-28. Results received: No. Last updated: 2026-04-20.
Decision dates by country: AT: 2024-10-14, BE: 2024-08-29, BG: 2024-09-13, CZ: 2024-09-03, DE: 2024-09-03, EE: 2024-09-02, ES: 2024-08-30, FR: 2024-09-02, HU: 2024-08-28, IT: 2024-09-04, LT: 2024-09-13, LV: 2024-09-16, NL: 2024-08-28, PL: 2024-10-05

Condition(s): Atopic Dermatitis
Product: Nemolizumab

Primary endpoint: Incidence and severity of treatment-emergent Aes throughout the study, Incidence of serious treatment-emergent Aes throughout the study, Incidence and severity of Aes of special interest (AESIs) throughout the study
Endpoint(s): Proportion of subjects with IGA score = 0-1 at each visit through Week 200, • Proportion of subjects with EASI-75 response at each visit through Week 200, Change and percent change from baseline in EASI at each visit through Week 200, Proportion of subjects with low disease activity state (ie, IGA ≤ 2) at each visit through Week 200, Change and percent change from baseline in SCORing Atopic Dermatitis (SCORAD) score at each visit through Week 200, Change and percent change from baseline in subject-reported pruritus using 10-cm visual analogue scale (SCORAD sub-component) to Week 200, Change and percent change from baseline in subject-reported sleep loss using 10-cm visual analogue scale (SCORAD sub-component) to Week 200, Proportion of subjects reporting low disease activity state (clear, almost clear, or mild) based on Patient Global Assessment of Disease 5-point scale at each visit up to Week 200, Proportion of subjects satisfied with study treatment (good, very good, or excellent) based on Patient Global Assessment of Treatment 5-point Likert scale at each visit up to Week 200, Change from baseline in Dermatology Life Quality Index (DLQI) or Children’s DLQI (cDLQI) total score at each visit through Week 200, Change from baseline in Patient-Oriented Eczema Measure (POEM) total score at each visit through Week 200, Change from baseline in Hospital Anxiety and Depression Scale (HADS) for each subscale (i.e., depression and anxiety) at each visit through Week 200, Change from baseline in Work Productivity and Activity Impairment: Atopic Dermatitis (WPAI:AD) for each subscale (i.e., work productivity and activity impairment) at each visit through Week 200, Change from baseline in EuroQoL 5-Dimension (EQ-5D) at each visit through Week 200, Proportion of subjects receiving any rescue therapy by rescue treatment type (e.g., topical, phototherapy, systemic) at any visit during the treatment period, Time to first relapse (relapse is defined as: worsening of AD requiring rescue therapy, if judged to be medically necessary by the investigator [i.e, clinically significant worsening of signs and/or symptoms of AD]), Duration of remission (time to first relapse in subjects with IGA=0 or 1 at baseline in the LTE), Time to permanent study drug discontinuation

Source: https://euclinicaltrials.eu/ctis-public/view/2024-514404-13-00